EU clinical trial 2024-517896-19-00: A dose-finding Phase I study of F8IL10 intra-articular treatment in Rheumatoid Arthritis
Protocol code: PH-F8IL10INTRA-03/24
Sponsor: Philogen S.p.A. (Pharmaceutical company). Phase: Human Pharmacology (Phase I)- Other. Countries: Italy (ongoing, recruiting).
Therapeutic area(s): Diseases [C] - Immune System Diseases [C20]
Gender: Female, Male. Age: 18-64 years, 65+ years. Enrolment: 42.
Status: Ongoing, recruiting. Start date (EU): 2025-09-29. Decision date: 2025-04-22. Results received: No. Last updated: 2025-12-10.

Condition(s): Patients with Rheumatoid Arthritis (RA) who, despite treatment with stable doses (for at least 3 months) of disease-modifying antirheumatic drugs (DMARDs, conventional, biologic and/or targeted synthetic), present arthritis flare(s) suitable for intra-articular (IA) injection in a knee, shoulder, ankle, wrist or elbow.

Source: https://euclinicaltrials.eu/ctis-public/view/2024-517896-19-00